EU clinical trial 2024-516016-17-00: A clinical study of MK-3214 in healthy people (MK-3214-001)
Protocol code: MK-3214-001
Sponsor: Merck Sharp & Dohme LLC (Pharmaceutical company). Phase: Human Pharmacology (Phase I)- First administration to humans. Countries: Belgium (ended).
Therapeutic area(s): Diseases [C] - Cardiovascular Diseases [C14]
Gender: Male. Age: 18-64 years. Enrolment: 32.
Status: Ended. Start date (EU): 2024-10-22. End date (EU): 2025-07-22. End date: 2025-07-23. Decision date: 2024-10-15. Results received: No. Last updated: 2025-04-10.

Condition(s): Hypercholesterolaemia

Source: https://euclinicaltrials.eu/ctis-public/view/2024-516016-17-00